EU clinical trial 2024-520153-21-00: An open label, balanced, randomized, two-treatment, two-period, two-sequence, single-dose, crossover, bioequivalence study comparing Clarithromycin tablets 500 mg, manufactured by Sun Pharmaceutical Industries Limited, India with Clarithromycin 500 mg coated tablets Manufactured by: Sanofi Medley Pharmaceuticals Ltd. Brazilian Industry, in healthy adult, human subjects under fasting condition.
Protocol code: CLARI-21-24
Sponsor: Sun Pharmaceutical Industries Limited (Pharmaceutical company). Phase: Human Pharmacology (Phase I)- Bioequivalence Study. Countries: Romania (ended).
Therapeutic area(s): Diseases [C] - Bacterial Infections and Mycoses [C01]
Gender: Female, Male. Age: 18-64 years. Enrolment: 52.
Status: Ended. Start date (EU): 2026-01-29. End date (EU): 2026-03-06. Decision date: 2025-06-11. Results received: No. Last updated: 2025-06-11.

Condition(s): Infectious diseases

Source: https://euclinicaltrials.eu/ctis-public/view/2024-520153-21-00